EU clinical trial 2024-514832-26-00: A Phase I/IIa, Randomized, Double-Blind, Placebo-Controlled, Single Dose and Single-Dose Challenge Study to Assess the Safety, Tolerability, Pharmacokinetics, and Efficacy of Intranasal EV25 in Healthy Volunteers and in Influenza Challenge Participants
Sponsor: Eradivir Inc. (Pharmaceutical company). Phase: Phase I and Phase II (Integrated)- First administration to humans. Countries: Belgium (ended).
Therapeutic area(s): Diseases [C] - Virus Diseases [C02]
Gender: Female, Male. Age: 18-64 years, 65+ years. Enrolment: 122.
Status: Ended. Start date (EU): 2024-11-12. End date (EU): 2025-05-13. Decision date: 2024-11-07. Results received: Yes. Last updated: 2024-11-07.

Condition(s): Virus Influenza
Product: Placebo for EV25 nasal spray, intranasal use, Wild-Type A Influenza Virus A/Belgium/4217/2015 (H3N2)

Primary endpoint: Part I: AEs, laboratory safety assessments,12-lead ECG findings, vital signs, physical examination findings, and intranasal administration site examination findings.

Source: https://euclinicaltrials.eu/ctis-public/view/2024-514832-26-00